EU clinical trial 2024-515577-10-00: Comparison of the effects of Belatacept and Anticalcineurins on endothelial function in kidney transplant patients - BELAFENDO
Protocol code: 2021/0391/HP
Sponsor: Centre Hospitalier Universitaire Rouen (Hospital/Clinic/Other health care facility). Phase: Therapeutic use (Phase IV). Countries: France (ongoing, recruiting).
Therapeutic area(s): Diseases [C] - Immune System Diseases [C20]; Phenomena and Processes [G] - Biological Phenomena [G16]; Phenomena and Processes [G] - Circulatory and Respiratory Physiological Phenomena [G09]
Gender: Female, Male. Age: 18-64 years, 65+ years. Enrolment: 44.
Status: Ongoing, recruiting. Start date (EU): 2025-07-24. Decision date: 2024-10-01. Results received: No. Last updated: 2026-01-26.

Condition(s): Kidney transplant
Product: NULOJIX 250 mg powder for concentrate for solution for infusion, TACROLIMUS, NATISPRAY 0,30 mg/dose spray sublinguale, CICLOSPORIN

Primary endpoint: The primary endpoint is to compare the 6-month change in the amplitude of endothelium-dependent dilation during the post-ischemic hyperemia maneuver (Section 7.1) (visit V2 and V3) measured by vascular ultrasound with automated real-time software analysis between the Belatacept group and the ancalcineurin group.
Endpoint(s): To compare the 6-month variation in the amplitude of endothelium-dependent dilation during distal skin heating (Section 6.1) (visits V2 and V3) measured by echotraking (Section 6.1) between the Belatacept group and the anticalcineurin group., Compare the 6-month variation in distensibility and Young's elastic modulus, indicators of carotid stiffness, will be measured 2 cm below the bifurcation by echotracking (Section 6.1)(visits V2 and V3) between the Belatacept group and the anticalcineurin group. And the 6-month variation in carotid-femoral PWV, an indicator of aortic stiffness, will be measured by applanation tonometry (Section 6.1)(visits V2 and V3) between the Belatacept group and the anticalcineurin group., To compare the 6-month change in brachial and carotid arterial pressure measurements and in the carotid augmentation index, an indicator of cardio-circulatory coupling, measured by applanation tonometry (Section 6.1) (visits V2 and V3) between the Belatacept group and the anticalcineurin group. The augmentation index is calculated as the difference between the systolic peak and the inflection in protosystole, expressed as a percentage of the central pulse pressure., To compare the 6-month variation in blood concentrations of nitrites and epoxyeicosatrienoic acids (EETs) (Section 6.1), an indicator of NO availability between 44°C and 34°C (visits V2 and V3) between the Belatacept group and the anticalcineurin group.

Source: https://euclinicaltrials.eu/ctis-public/view/2024-515577-10-00